EU clinical trial 2024-516942-21-00: An open label, randomized, single dose, two-sequence, two-treatment, four-period, fully replicate, cross-over pharmacokinetic study comparing Alverine citrate/Simeticone 60 mg/300 mg soft capsules to Meteospasmyl 60 mg/300 mg soft capsules in healthy male and female subjects under fed conditions.
Protocol code: 845900241/0147/1
Sponsor: Zaklady Farmaceutyczne Polpharma S.A. (Pharmaceutical company). Phase: Human Pharmacology (Phase I)- Bioequivalence Study. Countries: Czechia (ended).
Therapeutic area(s): Diseases [C] - Digestive System Diseases [C06]
Gender: Female, Male. Age: 18-64 years. Enrolment: 36.
Status: Ended. Start date (EU): 2024-10-21. End date (EU): 2024-12-06. Decision date: 2024-09-13. Results received: No. Last updated: 2024-11-06.

Condition(s): Not applicable (submitted trial is a bioavailability study in healthy subjects)

Source: https://euclinicaltrials.eu/ctis-public/view/2024-516942-21-00